EU clinical trial 2024-511033-35-00: Randomized placebo-controlled trial comparing Methotrexate vs. Methotrexate/Metformin association in rheumatoid arthritis patients: METorMET² study.
Protocol code: CHUBX 2016/44
Sponsor: Centre Hospitalier Universitaire De Bordeaux (Hospital/Clinic/Other health care facility). Phase: Therapeutic exploratory (Phase II). Countries: France (ended).
Therapeutic area(s): Phenomena and Processes [G] - Immune system processes [G12]
Gender: Female, Male. Age: 18-64 years, 65+ years. Enrolment: 128.
Status: Ended. Start date (EU): 2020-12-03. End date (EU): 2026-06-16. Decision date: 2024-07-09. Results received: No. Last updated: 2024-07-09.

Condition(s): rheumatoid arthritis (RA)
Product: FOLIC ACID, PL1, METFORMINE ARROW LAB 500 mg, comprimé pelliculé, METHOTREXATE, METHOTREXATE, PREDNISONE

Primary endpoint: Level of RA activity according to Disease Activity score on 28 joints (DAS28).
Endpoint(s): Proportion of patients who reach remission after 6, 12 and 24 months of treatment (DAS < 2,6)., Proportion of patients with low disease activity after 6 months of treatment (DAS < 3,2)., Proportion of patients for which a biologic treatment is introduced after 6, 12 and 24 months of treatment., Description of some metabolic parameters within the two groups of treatment: weight loss, waist circumference, fasting glycemia and hemoglobin A1c level (HbA1c), cholesterol levels, triglycerids, insulinemia, and bilirubin., Proportion of patients who present a serious adverse event within the two groups during the 6 months of treatment., Description of the evolution of functional assessment according to Health Assessment Questionnaire (HAQ) within the two groups during the 6 months of treatment.

Source: https://euclinicaltrials.eu/ctis-public/view/2024-511033-35-00